EU clinical trial 2024-515964-30-00: Access to Pirfenidone Solution for Inhalation (AP01) for Treatment of Progressive, Fibrosing Interstitial Lung Diseases, including Idiopathic Pulmonary Fibrosis
Protocol code: AP01-005
Sponsor: Avalyn Pharma Inc. (Pharmaceutical company). Phase: Therapeutic exploratory (Phase II). Countries: Netherlands (ended), Czechia (ended), Poland (ended).
Therapeutic area(s): Diseases [C] - Respiratory Tract Diseases [C08]
Gender: Female, Male. Age: 18-64 years, 65+ years. Enrolment: 33.
Status: Ended. Start date (EU): 2021-07-14. End date (EU): 2025-08-18. End date: 2025-08-19. Decision date: 2024-08-26. Results received: No. Last updated: 2025-06-18.
Decision dates by country: CZ: 2024-08-30, PL: 2024-09-16, NL: 2024-08-26

Condition(s): Interstitial Lung Diseases (ILD), including but not limited to idiopathic pulmonary fibrosis (IPF)
Product: Pirfenidone Solution for Inhalation

Endpoint(s): Treatment-emergent adverse events (AEs), Treatment-emergent deaths

Source: https://euclinicaltrials.eu/ctis-public/view/2024-515964-30-00